EU clinical trial 2025-522559-25-00: Repeated Mesenchymal Stem Cell Therapy for Radiation-Induced Hyposalivation and Xerostomia in Head and Neck Cancer Survivors
Sponsor: Rigshospitalet (Hospital/Clinic/Other health care facility). Phase: Therapeutic exploratory (Phase II). Countries: Denmark (authorised, recruitment pending).
Therapeutic area(s): Diseases [C] - Neoplasms [C04]; Diseases [C] - Otorhinolaryngologic Diseases [C09]
Gender: Female, Male. Age: 18-64 years, 65+ years. Enrolment: 100.
Status: Authorised, recruitment pending. Decision date: 2025-09-08. Results received: No. Last updated: 2025-09-08.

Condition(s): Xerostomia due to readiotherapy for a head & neck cancer
Product: Culture expanded Adipose Derived Regenerative Cells, ADRC001, Sterile Isotone Saline Water

Primary endpoint: The primary outcome measure will be unstimulated whole salivary flow rate (measured by sialometry) from baseline (t=0) to 8 months, assessed at baseline, 4, and 8 months. This domain has been chosen as whole salivary flow rate is observed to be the cardinal symptom in xerostomia[34]. The primary endpoint will be assessed as the difference between groups measured after 8 months in mL/min.

Source: https://euclinicaltrials.eu/ctis-public/view/2025-522559-25-00